EU clinical trial 2024-517230-17-00: Anakinra in Cerebral haemorrhage to Target secondary Injury resulting from Neuroinflammation - a phase II clinical trial
Protocol code: 109883
Sponsor: Stichting Radboud universitair medisch centrum (Hospital/Clinic/Other health care facility). Phase: Therapeutic exploratory (Phase II). Countries: Netherlands (ongoing, recruiting).
Therapeutic area(s): Diseases [C] - Nervous System Diseases [C10]
Gender: Female, Male. Age: 18-64 years, 65+ years. Enrolment: 75.
Status: Ongoing, recruiting. Start date (EU): 2024-10-28. Decision date: 2024-10-28. Results received: No. Last updated: 2024-10-28.

Condition(s): Intracerebral haemorrhage
Product: ANAKINRA

Primary endpoint: Oedema extension distance (OED) determined with MRI
Endpoint(s): (serious) Adverse events, Serum inflammatory markers IL-1β, IL-6, hsCRP, neutrophil and total white blood cell counts, DCE-MRI measurement of BBB transfer constant (Ktrans), mRS, Barthel index and EQ-5D-5L score

Source: https://euclinicaltrials.eu/ctis-public/view/2024-517230-17-00